EU clinical trial 2023-504550-35-00: A multicenter, single arm, open-label study to evaluate efficacy and safety of switching from anti-C5 antibody therapy to iptacopan therapy in study participants with aHUS
Protocol code: CLNP023F12302
Sponsor: Novartis Pharma AG (Pharmaceutical company). Phase: Therapeutic confirmatory (Phase III). Countries: Italy (ongoing, recruiting), Spain (ongoing, recruiting), Germany (ongoing, recruiting), France (ongoing, recruiting).
Therapeutic area(s): Diseases [C] - Immune System Diseases [C20]
Gender: Female, Male. Age: 18-64 years, 65+ years. Enrolment: 28.
Status: Ongoing, recruiting. Start date (EU): 2025-04-03. Decision date: 2024-01-31. Results received: No. Last updated: 2026-01-16.
Decision dates by country: ES: 2024-02-05, DE: 2024-02-01, IT: 2024-01-31, FR: 2024-02-02

Condition(s): Atypical Hemolytic Uremic Syndrome (aHUS)
Product: IPTACOPAN

Primary endpoint: Absence of TMA manifestation without use of anti-C5 antibody (for TMA manifestation) during 12 months of iptacopan treatment following the switch of treatment from an anti-C5 antibody to iptacopan treatment.
Endpoint(s): Absence of TMA manifestation without the use of anti-C5 antibody (for TMA manifestation) during 12 months of iptacopan treatment following the switch of treatment from an anti-C5 antibody to iptacopan treatment., Time to TMA manifestation during 12 Months of iptacopan treatment, Change from baseline in hematologic parameters (platelets, LDH, hemoglobin) and kidney function (serum creatinine, UPCR, eGFR, CKD stage) at Month 12 of iptacopan treatment., Dialysis requirement status (YES/NO) through 12 months of iptacopan treatment, Safety evaluations during 12 months of iptacopan treatment (including adverse events/serious adverse events, safety laboratory parameters and vital signs), TMA related events during 12 months of iptacopan treatment. TMA related events are defined as any of the following: • Irreversible (>3 months) reduction in estimated glomerular filtration rate (eGFR) by ≥20%, not attributable to another cause • An episode of acute kidney injury (AKI) attributed to a TMA that requires renal replacement therapy • A non-renal manifestation of a TMA that requires hospitalization, or causes irreversible organ damage or death.

Source: https://euclinicaltrials.eu/ctis-public/view/2023-504550-35-00